EU clinical trial 2024-511882-13-01: DAPAgliflozine to attenuate cardiac RemOdeling afTEr aCuTe myOcardial infarction (DAPA-PROTECTOR)
Protocol code: APHP211054
Sponsor: Assistance Publique Hopitaux De Paris (Hospital/Clinic/Other health care facility). Phase: Therapeutic confirmatory (Phase III). Countries: France (ongoing, recruitment ended).
Therapeutic area(s): Diseases [C] - Cardiovascular Diseases [C14]
Gender: Female, Male. Age: 18-64 years, 65+ years. Enrolment: 450.
Status: Ongoing, recruitment ended. Start date (EU): 2024-11-19. Decision date: 2024-11-19. Results received: No. Last updated: 2026-06-22.

Condition(s): Cardiac failure
Product: PLACEBO DE DAPAGLIFLOZIN 10 mg, DAPAGLIFLOZIN

Primary endpoint: Two primary endpoints will allow to evaluate two independent and potent predictors of mortality after AMI: 1)Cardiac systolic function, assessed by change in left ventricular ejection fraction (LVEF) from baseline to Month 6) (+4 weeks) by TTE, 2) Remodeling, assessed by change in left atrium volume (LAV) from baseline to Month 6 ) (+4 weeks) by TTE
Endpoint(s): Secondary endpoints: comparison in each group from baseline to Month 6 (+ 4 weeks) using TTE - Change in left ventricular end-systolic volume (LVESV) - Change in left ventricular end-diastolic volume (LVEDV) - Change in LV global longitudinal strain (LS) - Change in left atrial strain (LAS), Secondary endpoints: comparison between both groups (experimental vs. placebo) - Duration of hospital stay (index hospitalization) - All-cause mortality at 6-months - Cardiovascular death or worsening HF at 6-months - Number of re-admission due to HF at 6-months, Change from baseline to Month 6 (+ 4 weeks) in LVESV, LVEDV, LAV, LVEF, LV global LS, LAS and pulmonary congestion (normal lung, mild, moderate or severe ultrasound lung comets [ULCs]) using TTE at month 6 - Change from baseline to Month 6 (+ 4 weeks) in plasma levels of NT-pro BNP and HBA1C - Change in body weight from baseline to Month 6 (+4 weeks), Adverse events, with particular focus to those potentially related to dapagliflozin complications (e.g., all symptoms of volume depletion, major hypoglycemia, genital infections, diabetes ketoacidosis, changes in liver function parameters [ASAT, ALAT ≥3 USN], changes in renal function parameters [creatine x2, eGFR <30 mL/Min per 1.73m²]), fractures, and lower limb amputations) at Month 6)

Source: https://euclinicaltrials.eu/ctis-public/view/2024-511882-13-01